EU clinical trial 2023-505877-34-00: Upfront autologous hematopoietic stem cell transplantation versus immunosuppressive medication in early diffuse cutaneous systemic sclerosis: an international multicentre, open-label, randomized controlled trial (UPSIDE)
Protocol code: NL72607.041.20
Sponsor: University Medical Center Utrecht (Hospital/Clinic/Other health care facility). Phase: Therapeutic use (Phase IV). Countries: Sweden (authorised, recruiting), Netherlands (ongoing, recruiting), Italy (ongoing, recruiting).
Therapeutic area(s): Diseases [C] - Immune System Diseases [C20]
Gender: Female, Male. Age: 18-64 years. Enrolment: 78.
Start date (EU): 2020-08-18. Decision date: 2023-07-26. Results received: No. Last updated: 2024-07-23.
Decision dates by country: SE: 2023-07-26, NL: 2023-07-26, IT: 2023-09-01

Condition(s): Diffuse cutaneous systemic sclerosis according to the ACR/EULAR criteria
Product: CYCLOPHOSPHAMIDE, FILGRASTIM, MYCOPHENOLIC ACID, ANTITHYMOCYTE IMMUNOGLOBULIN (RABBIT)

Primary endpoint: Global Rank Composite Score (GRCS); an analytic tool that accounts for multiple disease manifestations simultaneously
Endpoint(s): Progression-free survival, defined as the time in days since the day of randomisation until any of the relative changes from baseline as defined in the protocol has been documented., Treatment related mortality is defined as any death during the study period following randomisation that cannot be attributed to progression of the disease according to the consensus opinion of the DSMB, Treatment toxicity will be assessed using WHO CTCAE v5.0 toxicity parameters (adverse events =/> grade 3) and infections according to the Bone Marrow Transplant Clinical Trials Network (BMT-CTN) grading (Appendix A), in consecutive 3-month periods following randomisation until five years follow-up., The area under the curve (AUC) of the CRISS over time, measuring the ‘predicted probability of being improved’ over 2 and 5 years. This AUC is calculated based on 4 repeated measures (6, 12, 18 and 24 months) with back translation to the original scale between 0 and 1., Change over years follow-up of the clinical parameters as defined in the protocol, Event-free survival at two years follow-up. Event-free survival is defined as the time in days from the day of randomisation until the occurrence of death due to any cause or the development of persistent major organ failure (heart, lung, kidney).

Source: https://euclinicaltrials.eu/ctis-public/view/2023-505877-34-00